EU clinical trial 2024-514639-10-00: “Impact of CardiolRx on Myocardial Recovery in patients with Acute Myocarditis. A double-blind, placebo-controlled trial (ARCHER)”
Protocol code: Cardiol 100-002
Sponsor: Cardiol Therapeutics Inc. (Pharmaceutical company). Phase: Therapeutic exploratory (Phase II). Countries: France (ended).
Therapeutic area(s): Diseases [C] - Cardiovascular Diseases [C14]
Gender: Female, Male. Age: 18-64 years, 65+ years. Enrolment: 35.
Status: Ended. Start date (EU): 2023-03-30. End date (EU): 2024-11-25. End date: 2025-02-04. Decision date: 2024-07-09. Results received: Yes. Last updated: 2025-01-28.

Condition(s): Acute Myocarditis
Product: CardiolRx

Primary endpoint: The primary outcome of this study is comprised of two primary endpoints; the difference in the means of each: extra cellular volume (ECV) and of global longitudinal strain (GLS), as measured by cardiac magnetic resonance (CMR) at 12 weeks post randomization between the active and the placebo groups.

Source: https://euclinicaltrials.eu/ctis-public/view/2024-514639-10-00